EU clinical trial 2025-522002-20-00: A trial to learn how safe AZD4063 is, how it moves throughout the body over time, and how it affects the levels of PLN mRNA in adults with dilated cardiomyopathy because of an R14del mutation in the PLN gene
Protocol code: D8340C00001
Sponsor: AstraZeneca AB (Pharmaceutical company). Phase: Human Pharmacology (Phase I)- First administration to humans. Countries: Netherlands (ongoing, recruiting).
Therapeutic area(s): Diseases [C] - Cardiovascular Diseases [C14]
Gender: Female, Male. Age: 18-64 years, 65+ years. Enrolment: 23.
Status: Ongoing, recruiting. Start date (EU): 2025-11-20. Decision date: 2025-11-03. Results received: No. Last updated: 2026-07-20.

Condition(s): PLN R14del Dilated Cardiomyopathy

Source: https://euclinicaltrials.eu/ctis-public/view/2025-522002-20-00